EU clinical trial 2022-502070-16-00: Study of GS-4528 for Adults With Solid Tumors
Protocol code: GS-US-616-6291
Sponsor: Gilead Sciences Inc. (Pharmaceutical company). Phase: Human Pharmacology (Phase I)- First administration to humans. Countries: Spain (ended).
Therapeutic area(s): Diseases [C] - Neoplasms [C04]
Gender: Female, Male. Age: 18-64 years, 65+ years. Enrolment: 41.
Status: Ended. Start date (EU): 2023-10-02. End date (EU): 2026-05-25. Decision date: 2023-07-24. Results received: No. Last updated: 2026-02-27.

Condition(s): Solid Tumors

Source: https://euclinicaltrials.eu/ctis-public/view/2022-502070-16-00